EU clinical trial 2022-502779-40-00: A randomized, double-blind, placebo-controlled multicenter study to evaluate the effect of inclisiran on preventing major adverse cardiovascular events in high-risk primary prevention patients (VICTORION-1 PREVENT)
Protocol code: CKJX839D12302
Sponsor: Novartis Pharma AG (Pharmaceutical company). Phase: Therapeutic confirmatory (Phase III). Countries: Lithuania (ongoing, recruitment ended), Netherlands (ongoing, recruitment ended), Croatia (ongoing, recruitment ended), Spain (ongoing, recruitment ended), Greece (ongoing, recruitment ended), Bulgaria (ongoing, recruitment ended), Poland (ongoing, recruitment ended), Czechia (ongoing, recruitment ended), Belgium (ongoing, recruitment ended), Latvia (ongoing, recruitment ended), Estonia (ongoing, recruitment ended), Portugal (ongoing, recruitment ended), Denmark (ongoing, recruitment ended), Sweden (ongoing, recruitment ended), Hungary (ongoing, recruitment ended), Austria (ongoing, recruitment ended), Romania (ongoing, recruitment ended), Slovakia (ongoing, recruitment ended), France (ongoing, recruitment ended), Italy (ongoing, recruitment ended).
Therapeutic area(s): Diseases [C] - Cardiovascular Diseases [C14]
Gender: Female, Male. Age: 18-64 years, 65+ years. Enrolment: 5173.
Status: Ongoing, recruitment ended. Start date (EU): 2023-09-04. Decision date: 2023-08-16. Results received: No. Last updated: 2026-07-13.
Decision dates by country: BG: 2023-08-21, SE: 2023-08-17, AT: 2023-08-21, LV: 2023-08-17, CZ: 2023-08-17, HR: 2023-08-21, SK: 2023-08-17, FR: 2023-08-18, LT: 2023-08-17, GR: 2023-08-21, PT: 2023-08-16, DK: 2023-08-17, RO: 2023-08-21, HU: 2023-08-21, NL: 2023-08-21, BE: 2023-08-17, EE: 2023-08-21, PL: 2023-08-21, ES: 2023-08-17, IT: 2023-08-18

Condition(s): Primary prevention of atherosclerotic cardiovascular disease (ASCVD)
Product: INCLISIRAN, Placebo to KJX839 (Inclisiran) 0 mg/1.5 mL solution for injection in pre-filled syringe

Primary endpoint: Time to the first occurrence of 4P-MACE
Endpoint(s): Time to the first occurrence of 3P-MACE., Times to the occurrences of CV death, nonfatal MI, non-fatal ischemic stroke, and urgent coronary revascularization (first and recurrent)., Times to the occurrences of CV death, nonfatal MI, and non-fatal ischemic stroke (first and recurrent)., Time to CV death., Time to all-cause mortality., Number of participants with SAEs., Number of participants with AEs leading to study treatment discontinuation.

Source: https://euclinicaltrials.eu/ctis-public/view/2022-502779-40-00